EU clinical trial 2025-523872-22-00: Research into the safety of a new agent (NRG5051) in healthy adults and patients with Parkinson's disease or ALS
Protocol code: NRG5051-101
Sponsor: Nrg Therapeutics Limited (Pharmaceutical company). Phase: Human Pharmacology (Phase I)- First administration to humans. Countries: Netherlands (ongoing, recruiting).
Therapeutic area(s): Diseases [C] - Nervous System Diseases [C10]
Gender: Female, Male. Age: 18-64 years, 65+ years. Enrolment: 118.
Status: Ongoing, recruiting. Start date (EU): 2025-11-18. Decision date: 2025-11-17. Results received: No. Last updated: 2026-07-09.

Condition(s): Parkinsons's Disease and amyotrophic lateral sclerosis (ALS)

Source: https://euclinicaltrials.eu/ctis-public/view/2025-523872-22-00